EU clinical trial 2023-504821-38-00: An Open-label, Uncontrolled, Multicenter Phase II Trial of MK-3475 (Pembrolizumab) in Children and Young Adults with Newly Diagnosed Classical Hodgkin Lymphoma with Inadequate (Slow Early) Response to Frontline chemotherapy (KEYNOTE 667).
Protocol code: MK-3475-667
Sponsor: Merck Sharp & Dohme LLC (Pharmaceutical company). Phase: Therapeutic exploratory (Phase II). Countries: Netherlands (ongoing, recruitment ended), Slovakia (ongoing, recruitment ended), Germany (ongoing, recruitment ended), Czechia (ongoing, recruitment ended), Italy (ongoing, recruitment ended), France (ongoing, recruitment ended), Spain (ongoing, recruitment ended), Greece (ended).
Therapeutic area(s): Diseases [C] - Neoplasms [C04]
Gender: Female, Male. Age: 0-17 years, 18-64 years. Enrolment: 243.
Start date (EU): 2019-09-19. Decision date: 2023-11-20. Results received: No. Last updated: 2026-03-23.
Decision dates by country: GR: 2024-05-13, NL: 2023-11-20, SK: 2023-11-20, CZ: 2023-11-21, DE: 2023-11-23, IT: 2023-11-27, FR: 2023-11-23, ES: 2023-11-27

Condition(s): Classical Hodgkin lymphoma in children and young adults
Product: BLEOMYCIN, KEYTRUDA 25 mg/mL concentrate for solution for infusion, VINBLASTINE, CYCLOPHOSPHAMIDE, ETOPOSIDE, DACARBAZINE, PREDNISOLONE, VINCRISTINE, PREDNISONE, DOXORUBICIN

Primary endpoint: Objective Response Rate (ORR) in SER Participants By Risk Group (Low, High) as assessed by Blinded Independent Central Review (BICR)
Endpoint(s): Rate of Positron Emission Tomography (PET) Scan Negativity in SER Participants By Risk Group (Low, High) After AVD (Doxorubicin, vinblastine and dacarbazine) or COPDAC-28 (cyclophosphamide, vincristine, prednisone, and dacarbazine) Chemotherapy, Event-Free Survival (EFS) in SER Participants By Risk Group (Low, High) as Assessed by BICR, Overall Survival (OS) in SER Participants By Risk Group (Low, High), Exposure to Radiotherapy (RT) in SER Participants By Risk Group (Low, High), Rate of PET Scan Negativity In Group 1 Participants After ABVD Induction Therapy, EFS in Rapid Early Responder (RER) Participants By Risk Group (Low, High) as Assessed by Investigator, OS in RER Participants By Risk Group (Low, High), Serum Thymus and Activation-Regulated Chemokine (TARC) Levels in SER Participants By Risk Group (Low, High), Number of SER Participants Experiencing an Adverse Event (AE) By Risk Group (Low, High), Number of SER Participants Discontinuing Study Treatment Due to AEs By Risk Group (Low, High)

Source: https://euclinicaltrials.eu/ctis-public/view/2023-504821-38-00